EU clinical trial 2023-505170-15-00: A Phase 3 Open-label Extension Study to Assess the Long-term Safety and Efficacy of Intravenous ATB200 Co-administered With Oral AT2221 in Adult Subjects With Late-onset Pompe Disease
Protocol code: ATB200-07
Sponsor: Amicus Therapeutics Inc. (Pharmaceutical company). Phase: Therapeutic confirmatory (Phase III). Countries: Slovenia (ongoing, recruitment ended), France (ongoing, recruitment ended), Italy (ended), Belgium (ended), Poland (ongoing, recruitment ended), Netherlands (ended), Greece (ended), Hungary (ongoing, recruitment ended), Denmark (ended).
Therapeutic area(s): Diseases [C] - Congenital, Hereditary, and Neonatal Diseases and Abnormalities [C16]
Gender: Female, Male. Age: 18-64 years, 65+ years. Enrolment: 34.
Start date (EU): 2020-05-15. Decision date: 2024-07-12. Results received: No. Last updated: 2026-05-31.
Decision dates by country: GR: 2024-07-19, NL: 2024-07-18, BE: 2024-07-17, IT: 2024-07-24, DK: 2024-07-12, SI: 2024-07-18, HU: 2024-07-18, PL: 2024-08-06, FR: 2024-07-17

Condition(s): Adult Subjects With Late Onset Pompe Disease (LOPD)
Product: ATB200, AT2221

Primary endpoint: Long-term safety: incidence of treatment-emergent adverse events (TEAEs), serious adverse events (SAEs), and AEs leading to discontinuation of study drug, frequency and severity of immediate and late IARs, and any abnormalities noted in other safety assessments (eg, clinical laboratory tests, ECGs, vital signs). Immunogenicity to ATB200 will also be described
Endpoint(s): Change from baseline in 6-minute walk distance (6MWD), Change from baseline in 6MWD (% predicted), Change from baseline in sitting FVC (% predicted), Change from baseline in the manual muscle test score for the lower extremities, Change from baseline in the total score for the PROMIS – physical function, Change from baseline in the total score for the PROMIS – fatigue, Change from baseline in the following variables related to motor function: - GSGC total score, - time to complete the 10-meter walk (ie, assessment of gait) of the GSGC test, - time to complete the 4-stair climb of the GSGC test, - time to complete the Gower's maneuver of the GSGC test, - time to arise from a chair as part of the GSGC test, - change from baseline in the time to complete the TUG test, Change from baseline in the following variables related to muscle strength: - manual muscle test score for the upper extremities, - manual muscle test total score (upper and lower extremities combined), - quantitative muscle test value (kg) for the upper extremities, - quantitative muscle test value (kg) for the lower extremities, - quantitative muscle test total value (kg) (upper and lower extremities combined), Change from baseline in the following variables from patient-reported outcome measures: - total score for the PROMIS-dyspnea, - total score for the PROMIS–upper extremity, - R-PAct Scale total score, - EQ-5D-5L health status, Actual value of the subject's functional status (improving, stable, or declining) pertaining to the effects of study drug in the following areas of life, as measured by the SGIC: - overall physical well-being, - effort of breathing, - muscle strength, - muscle function, - ability to move around, - activities of daily living, - energy level, - level of muscular pain, Actual value of the subject's functional status (improving, stable, or declining), as measured by the PGIC, Change from baseline in the following measures of pulmonary function, as follows: - sitting SVC (% predicted), - MIP (cmH2O), - MIP (% predicted), - MEP (cmH2O), - MEP (% predicted), - SNIP (cmH2O), Change from baseline in serum CK level, Change from baseline in urinary Hex4 level

Source: https://euclinicaltrials.eu/ctis-public/view/2023-505170-15-00